EU clinical trial 2022-502105-15-00: A Phase 2, Multicenter, Multinational, Randomized, Double-blind, Placebo-controlled Study to Assess the Safety, Efficacy, and Pharmacokinetics of Multiple Dose Levels of ESK-001 in Adult Patients with Systemic Lupus Erythematosus
Protocol code: ESK-001-010
Sponsor: Alumis Inc. (Laboratory/Research/Testing facility). Phase: Therapeutic exploratory (Phase II). Countries: Spain (ongoing, recruitment ended), Germany (ongoing, recruitment ended), Poland (ongoing, recruitment ended), Romania (ongoing, recruitment ended), Denmark (ongoing, recruitment ended), Bulgaria (ongoing, recruitment ended), Croatia (ongoing, recruitment ended), Hungary (ended).
Therapeutic area(s): Diseases [C] - Immune System Diseases [C20]
Gender: Female, Male. Age: 18-64 years, 65+ years. Enrolment: 136.
Start date (EU): 2023-10-20. Decision date: 2023-08-28. Results received: No. Last updated: 2026-06-16.
Decision dates by country: HU: 2023-08-28, RO: 2023-08-29, DE: 2023-08-29, HR: 2023-08-29, PL: 2023-08-29, ES: 2023-08-28, BG: 2023-08-29, DK: 2023-08-28

Condition(s): Systemic lupus erythematosus
Product: ESK-001, Placebo, tablet

Primary endpoint: The composite endpoint defined by meeting all of the criteria as described in Protocol Section 2 “Study Objectives and Endpoints”.
Endpoint(s): Incidence of treatment-emergent AEs (TEAEs) and SAEs, vital signs, physical examination, 12-lead ECG, and clinical laboratory tests (hematology, clinical chemistry, urinalysis); other measurements and composite endpoints as described in Protocol Section 2 “Study Objectives and Endpoints”.

Source: https://euclinicaltrials.eu/ctis-public/view/2022-502105-15-00